EU clinical trial 2024-516247-62-00: A Phase 3, Randomized, Double-blind, Placebo-controlled Study to Evaluate the Efficacy and Safety of Orally Administered Deucrictibant Extended-release Tablet for Prophylaxis Against Angioedema Attacks in Adolescents and Adults with Hereditary Angioedema
Protocol code: PHA022121-C305
Sponsor: Pharvaris Netherlands B.V. (Pharmaceutical company). Phase: Therapeutic confirmatory (Phase III). Countries: France (ended), Bulgaria (ended), Slovakia (ended), Hungary (ended), Ireland (ended), Poland (ended), Romania (ended), Italy (ended), Spain (ended), Germany (ended).
Therapeutic area(s): Diseases [C] - Immune System Diseases [C20]
Gender: Female, Male. Age: 0-17 years, 18-64 years, 65+ years. Enrolment: 37.
Status: Ended. Start date (EU): 2025-03-10. End date (EU): 2026-07-21. End date: 2026-07-22. Decision date: 2025-02-12. Results received: No. Last updated: 2026-07-17.
Decision dates by country: BG: 2025-02-12, FR: 2025-02-14, DE: 2025-05-21, HU: 2025-02-14, ES: 2025-02-13, PL: 2025-02-17, IE: 2025-02-14, RO: 2025-02-14, SK: 2025-02-17, IT: 2025-02-13

Condition(s): Hereditary Angioedema
Product: Matched to test Product Deucrictibant extended release tablets with the exception of active substance, Deucrictibant (PHA-022121), ICATIBANT

Primary endpoint: Time-normalized (per 4 weeks) number of Investigator confirmed HAE attacks during the 24 week Treatment Period (Day 1 through Day 168)
Endpoint(s): Time-normalized number of Investigator confirmed HAE attacks treated with on-demand medication during the 24 week Treatment Period, Time-normalized number of Investigator confirmed moderate or severe HAE attacks during the 24 week Treatment Period, Time-normalized number of Investigator confirmed severe HAE attacks during the 24 week Treatment Period, Proportion of participants achieving ≥50% reduction in HAE attack rate relative to baseline during the 24 week Treatment Period, Proportion of participants achieving ≥70% reduction in HAE attack rate relative to baseline during the 24 week Treatment Period, Proportion of participants achieving ≥90% reduction in HAE attack rate relative to baseline during the 24 week Treatment Period, Proportion of participants that are HAE attack-free during the 24 week Treatment Period, Proportion of time without angioedema symptoms during the 24 week Treatment Period, Treatment-emergent adverse events (TEAEs), including serious adverse events (SAEs), adverse events of special interest (AESIs), and TEAEs leading to study drug discontinuation, Changes in clinical laboratory tests from baseline, Changes in vital signs from baseline, Changes in electrocardiogram (ECG) parameters from baseline, Deucrictibant plasma concentration-time profiles, Angioedema Quality of Life (AE-QoL) questionnaire, Patient Global Assessment of Change (PGA-Change), Angioedema Control Test 4-week version (AECT-4wk), Work Productivity and Activity Impairment Questionnaire: Specific Health Problem (WPAI-SHP), Abbreviated Treatment Satisfaction Questionnaire for Medication (TSQM-9)

Source: https://euclinicaltrials.eu/ctis-public/view/2024-516247-62-00